EU clinical trial 2023-505659-27-00: A Phase 2, Open-Label, Multi-Center Study of Venetoclax in Combination with Carfilzomib and Dexamethasone in Subjects with Relapsed or Refractory Multiple Myeloma
Protocol code: M15-538
Sponsor: AbbVie Deutschland GmbH & Co. KG (Pharmaceutical company). Phase: Therapeutic exploratory (Phase II). Countries: Spain (ongoing, recruitment ended), Hungary (ended).
Therapeutic area(s): Diseases [C] - Neoplasms [C04]
Gender: Female, Male. Age: 18-64 years, 65+ years. Enrolment: 25.
Start date (EU): 2020-10-21. Decision date: 2023-10-24. Results received: No. Last updated: 2026-07-06.
Decision dates by country: HU: 2023-10-25, ES: 2023-10-24

Condition(s): Multiple Myeloma
Product: Dexamethasone 4 mg tablets, Kyprolis 60 mg powder for solution for infusion, Venetoclax

Primary endpoint: To assess the safety and tolerability of venetoclax in combination with carfilzomib and dexamethasone when administered in subjects with relapsed or refractory multiple myeloma (RRMM)., To explore and compare safety and preliminary efficacy of VenKd combination at 400 mg or 800 mg venetoclax dose levels with carfilzomib dexamethasone (Kd) (control) regimen. International Myeloma Working Group (IMWG) response rates (per investigator) including ORR, VGPR, or better rate, and complete response (CR) or better rate will be investigated., To assess the objective response rate (ORR) and very good partial response (VGPR) or better rate of venetoclax carfilzomib dexamethasone (VenKd) at the target dose combination in subjects with RRMM, and in t(11;14)-positive RRMM subjects.
Endpoint(s): To investigate the IMWG response rates for subjects with high BCL-2 expression, and for subjects with prior exposure to lenalidomide., To assess the time-to-event endpoints: progression-free survival (PFS), time to response (TTR), time to progression (TTP), duration of response (DOR), and overall survival (OS) of the VenKd combination in RRMM subjects., To characterize the pharmacokinetics (PK) in plasma of venetoclax and carfilzomib., To assess minimal residual disease (MRD) in the bone marrow by next generation sequencing (NGS).

Source: https://euclinicaltrials.eu/ctis-public/view/2023-505659-27-00